EU clinical trial 2024-516655-40-00: Open label, Phase I study to assess and compare the pharmacokinetic parameters after multiple oral administration of stiripentol 1000 mg in renal impaired patients and matching controls with normal renal function
Protocol code: STP237
Sponsor: Biocodex (Pharmaceutical company). Phase: Human Pharmacology (Phase I)- Other. Countries: Bulgaria (ended).
Therapeutic area(s): Not possible to specify
Gender: Female, Male. Age: 18-64 years, 65+ years. Enrolment: 48.
Status: Ended. Start date (EU): 2023-06-02. End date (EU): 2024-11-30. Decision date: 2024-11-27. Results received: No. Last updated: 2024-11-27.

Condition(s): Patients with renal impairement

Source: https://euclinicaltrials.eu/ctis-public/view/2024-516655-40-00